EU clinical trial 2024-519623-23-00: A multicenter, prospective, randomized, double blind, placebo controlled, adaptive design study performed to evaluate the efficacy and the safety of EscharEx in debridement of Venous Leg Ulcers (VALUE)
Protocol code: MW2022-06-22
Sponsor: Mediwound Ltd. (Pharmaceutical company). Phase: Therapeutic confirmatory (Phase III). Countries: Austria (ongoing, recruiting), Italy (ongoing, recruiting), Germany (ongoing, recruiting), Poland (ongoing, recruiting).
Therapeutic area(s): Diseases [C] - Skin and Connective Tissue Diseases [C17]
Gender: Female, Male. Age: 18-64 years, 65+ years. Enrolment: 99.
Status: Ongoing, recruiting. Start date (EU): 2025-10-20. Decision date: 2025-06-11. Results received: No. Last updated: 2026-07-27.
Decision dates by country: IT: 2025-06-11, PL: 2025-06-16, DE: 2025-06-11, AT: 2025-06-11

Condition(s): Venous leg ulcer
Product: Placebo (Gel Vehicle), Amnion/Chorion Membrane Allograft, EscharEx

Primary endpoint: Incidence of complete debridement, clinically (visually) assessed after each application during the Daily Visits Period (up to 8 applications),, Facilitation of wound closure, as measured by time to complete wound closure, clinically assessed from the initiation of study treatment until the end of the Weekly Visits Period.
Endpoint(s): Incidence of complete healthy viable granulation tissue, at the end of the Daily Visits Period, as assessed clinically, Time to the first declaration of complete debridement, clinically assessed, from the initiation of study treatment until the end of the Weekly Visits Period, Time to Wound Bed Prepared, clinically assessed, from the initiation of study treatment until the end of the Weekly Visits Period, Incidence of complete wound closure, clinically assessed, from the initiation of study treatment, until the end of the Weekly Visits Period.

Source: https://euclinicaltrials.eu/ctis-public/view/2024-519623-23-00